EU clinical trial 2024-519811-32-00: An interventional, Open-label Study to Evaluate the effect of lebrikizumab on eczema and Skin Barrier Function parameters in lesional and non-lesional skin in Adults and Adolescents with Moderate to Severe Atopic Dermatitis
Protocol code: BARRAD
Sponsor: Region Oestergoetland (Hospital/Clinic/Other health care facility). Phase: Therapeutic use (Phase IV). Countries: Sweden (authorised, recruitment pending).
Therapeutic area(s): Diseases [C] - Skin and Connective Tissue Diseases [C17]
Gender: Female, Male. Age: 0-17 years, 18-64 years. Enrolment: 30.
Status: Authorised, recruitment pending. Decision date: 2026-02-12. Results received: No. Last updated: 2026-02-12.

Condition(s): Atopic dermatitis
Product: Ebglyss 250 mg solution for injection in pre-filled pen

Primary endpoint: The percentage of patients achieving EASI-75 (≥75% reduction from Baseline in EASI score) at Week 24, the final visit of the study.
Endpoint(s): Alternative clinically evaluated endpoint measures (IGA ≤1 and≥2 point improvement; DLQI≥4 point improvement; NRS ≥4 point improvement);, Registry-based (EG: SwedAD) PROMS (POEM, MADRS-S, RECAP), Skin physiological outcome measures in the form of EIS in all patients and evaporimetry, Epsilon and TiVi in a subgroup, NMF and Skin lipid sampling (tape stripping in all and biopsy for ToF-SIMS in an adult subgroup, Vitamin D status in blood and skin biopsy (adults only)

Source: https://euclinicaltrials.eu/ctis-public/view/2024-519811-32-00